EU clinical trial 2023-509077-23-00: A Multi-center, Randomized, Double-blind, Placebo-controlled Trial to Evaluate the Neurological Effects of EryDex on subjects with Ataxia-Telangiectasia.
Protocol code: IEDAT-04-2022
Sponsor: Quince Therapeutics S.p.A. (Pharmaceutical company). Phase: Therapeutic confirmatory (Phase III). Countries: Poland (ended), Norway (ended), Denmark (ended), Germany (ended), Spain (ended), Belgium (ended), Italy (ended).
Therapeutic area(s): Diseases [C] - Nervous System Diseases [C10]; Diseases [C] - Congenital, Hereditary, and Neonatal Diseases and Abnormalities [C16]
Gender: Female, Male. Age: 0-17 years, 18-64 years. Enrolment: 67.
Status: Ended. Start date (EU): 2024-06-03. End date (EU): 2025-12-17. End date: 2025-12-18. Decision date: 2024-04-29. Results received: Yes. Last updated: 2026-01-14.
Decision dates by country: BE: 2024-07-29, DK: 2024-05-22, PL: 2024-05-06, IT: 2024-05-22, ES: 2024-05-22, DE: 2024-06-12, NO: 2024-05-22

Condition(s): Ataxia Telangiectasia
Product: Sodium chloride 0.372% solution, Dexamethasone sodium phosphate for encapsulation into autoerythrocytes

Primary endpoint: Primary Efficacy Endpoint= To evaluate the effect of EryDex on CNS symptoms, as measured by the change of the RmICARS from baseline to Visit 9 compared to placebo in A-T (6- to 9-year-old participants primary analysis population).
Endpoint(s): Key Secondary Efficacy Endpoint = To evaluate the overall clinical effect of EryDex, compared to placebo, in A-T (6- to 9-year-old participants primary analysis population), based on CGI-S from baseline to Visit 9 (Day 168), Other Secondary Efficacy Endpoint = CGI-C from baseline to Visit 9 (Day 168)

Source: https://euclinicaltrials.eu/ctis-public/view/2023-509077-23-00